EU clinical trial 2024-512071-12-00: The role of online sleep intervention and hormone therapy on sleep, climacteric symptoms and mood in the perimenopause
Protocol code: NL87156.018.24
Sponsor: Amsterdam UMC Stichting (Hospital/Clinic/Other health care facility). Phase: Therapeutic use (Phase IV). Countries: Netherlands (ongoing, recruiting).
Therapeutic area(s): Psychiatry and Psychology [F] - Mental Disorders [F03]
Gender: Female. Age: 18-64 years. Enrolment: 222.
Status: Ongoing, recruiting. Start date (EU): 2025-10-29. Decision date: 2025-03-21. Results received: No. Last updated: 2025-10-22.

Condition(s): Insomnia, Climacteric symptoms
Product: Utrogestan, capsules, Systen 50, pleisters voor transdermaal gebruik 50 microgram/24 uur

Primary endpoint: The primary outcome variable is the difference between the groups in the within-subject change in insomnia severity at T1 (2 months) and T2 (4 months) relative to T0 (baseline). Insomnia severity will be assessed with the Insomnia Severity Index (ISI) (Bastien et al., 2001) at these three timepoints.
Endpoint(s): Other sleep outcomes: subjective sleep efficiency (sleep diary), objective sleep efficiency, REM sleep fragmentation (EEG headband)., Depressive symptoms: IDS-SR, Other mental health outcomes: RMT-20, PMH scale, MHQoL, EuroQoL, Wellbeing and daytime functioning: PLB, Cantrill's ladder, Climacteric symptoms: GCS, HFRDIS, objective frequency hotflushes (watch), Individual differences: Sleep history (questionnaire), CTQ, PSST, EPDS

Source: https://euclinicaltrials.eu/ctis-public/view/2024-512071-12-00